EU clinical trial 2022-500669-28-00: Senolytics to Improve Osteoporosis therapy: A randomised controlled clinical trial The SENIOR Trial
Sponsor: Odense University Hospital (Hospital/Clinic/Other health care facility). Phase: Therapeutic exploratory (Phase II). Countries: Denmark (not authorised).
Therapeutic area(s): Diseases [C] - Hormonal diseases [C19]; Diseases [C] - Nutritional and Metabolic Diseases [C18]
Gender: Female, Male. Age: 18-64 years, 65+ years. Enrolment: 120.
Status: Not authorised. Decision date: 2022-08-25. Results received: No. Last updated: 2022-08-25.

Condition(s): Osteoporosis, Osteopenia
Product: DASATINIB

Primary endpoint: Change in circulating marker of bone resorption (CTX) at 20 weeks.
Endpoint(s): Bone resorption marker tartrate resistant acid phosphatase (TRAcP) at 20 weeks., Bone formation markers (PINP, osteocalcin, and bone alkaline phosphatase) at 20 weeks.

Source: https://euclinicaltrials.eu/ctis-public/view/2022-500669-28-00